EU clinical trial 2024-519007-10-00: NeoAspMet - Neoadjuvant Aspirin and/or Metformin during preoperative induction chemotherapy and chemoradiotherapy for locally-advanced rectal cancer. A multi-arm, multi-stage, intergroup (STAR-04/SICO-CR01/GISCAD/AIRO-GI) randomised clinical trial. The NeoAspMet trial
Sponsor: IRCCS Istituto Nazionale Tumori Fondazione Pascale (Hospital/Clinic/Other health care facility). Phase: Phase II and Phase III (Integrated). Countries: Italy (ongoing, recruiting).
Therapeutic area(s): Diseases [C] - Neoplasms [C04]
Gender: Female, Male. Age: 18-64 years, 65+ years. Enrolment: 340.
Status: Ongoing, recruiting. Start date (EU): 2020-10-22. Decision date: 2025-01-10. Results received: No. Last updated: 2026-07-29.

Condition(s): Locally advanced stage II/III rectal cancer
Product: METFORMIN, CAPECITABINE, OXALIPLATIN, ACETYLSALICYLIC ACID

Primary endpoint: Good Pathological Response (GPR) defined as Tumour downstaging (ypT0 or ypT1) irrespective of the pathological N stage
Endpoint(s): Tumor Regression Rate Pathological complete responses (pCR) NeoAdjuvant Rectal (NAR) score MRI Tumor Downstaging (mr TGR) rate Event-Free Survival (EFS) Overall Survival (OS) Time to Distant Recurrence (TDR) Rate of local recurrence at 3 years Abdominal Perineal Resection (APR) rate Organ preservation rate at 3 years Post-operative complications Treatment-related toxicity Quality of Life (QoL). For further information please see protocol

Source: https://euclinicaltrials.eu/ctis-public/view/2024-519007-10-00